EU clinical trial 2025-522585-72-00: Efficacy of top-down therapy with mirikizumab versus standard of care with azathioprine in patients with newly diagnosed moderate-to-severe ulcerative colitis: A 52-week, multicenter, open-label, randomized controlled trial
Protocol code: MIRACLE
Sponsor: Universitaetsklinikum Schleswig-Holstein AöR (Hospital/Clinic/Other health care facility). Phase: Therapeutic use (Phase IV). Countries: Germany (ongoing, recruiting).
Therapeutic area(s): Diseases [C] - Digestive System Diseases [C06]
Gender: Female, Male. Age: 18-64 years, 65+ years. Enrolment: 300.
Status: Ongoing, recruiting. Start date (EU): 2025-12-05. Decision date: 2025-09-26. Results received: No. Last updated: 2026-06-08.

Condition(s): ulcerative colitis
Product: MIRIKIZUMAB, MIRIKIZUMAB, AZATHIOPRINE

Primary endpoint: The proportion of patients achieving comprehensive disease control at Week 52.

Source: https://euclinicaltrials.eu/ctis-public/view/2025-522585-72-00